EU clinical trial 2025-522005-38-00: Evaluation of the efficacy of iloprost in the management of vaso-occlusive crises in adult patients with sickle cell: a multicentre, randomised, double-blind, placebo-controlled study _ PROSTASICKLE
Protocol code: 2020/0421/HP
Sponsor: Centre Hospitalier Universitaire Rouen (Hospital/Clinic/Other health care facility). Phase: Therapeutic confirmatory (Phase III). Countries: France (authorised, recruitment pending).
Therapeutic area(s): Diseases [C] - Congenital, Hereditary, and Neonatal Diseases and Abnormalities [C16]
Gender: Female, Male. Age: 18-64 years, 65+ years. Enrolment: 144.
Status: Authorised, recruitment pending. Decision date: 2026-03-09. Results received: No. Last updated: 2026-03-09.

Condition(s): sickle cell anaemia with vaso-occlusive crisis
Product: ILOPROST ZENTIVA 100 microgrammes/mL, solution à diluer pour perfusion, Glucose 5 % Fresenius Kabi, solution pour perfusion

Primary endpoint: Mean opioid consumption in morphine equivalent mg/day over the 28 days following randomization

Source: https://euclinicaltrials.eu/ctis-public/view/2025-522005-38-00